EU clinical trial 2025-524316-11-00: A Phase 3, Randomized, Double-blind, Efficacy and Safety Study Comparing Orelabrutinib to Placebo in Patients With Primary Progressive Multiple Sclerosis
Protocol code: ZB020-03-001
Sponsor: Zenas Biopharma (USA) LLC (Pharmaceutical company). Phase: Therapeutic confirmatory (Phase III). Countries: Italy (authorised, recruiting), Finland (authorised, recruiting), Bulgaria (authorised, recruiting), Greece (authorised, recruiting), Belgium (authorised, recruiting), Estonia (authorised, recruiting), Portugal (authorised, recruiting), Spain (authorised, recruiting), Germany (authorised, recruiting), France (authorised, recruiting), Czechia (authorised, recruiting), Slovakia (authorised, recruiting), Romania (authorised, recruiting), Croatia (authorised, recruiting), Poland (ongoing, recruiting), Austria (authorised, recruiting), Netherlands (authorised, recruiting), Denmark (authorised, recruiting), Sweden (authorised, recruiting), Hungary (not authorised).
Therapeutic area(s): Diseases [C] - Nervous System Diseases [C10]
Gender: Female, Male. Age: 18-64 years. Enrolment: 398.
Start date (EU): 2026-06-11. Decision date: 2026-05-18. Results received: No. Last updated: 2026-07-21.
Decision dates by country: AT: 2026-05-25, BE: 2026-05-19, BG: 2026-05-20, HR: 2026-05-25, CZ: 2026-05-19, DK: 2026-05-18, EE: 2026-05-21, FI: 2026-05-19, FR: 2026-05-20, GR: 2026-05-19, HU: 2026-05-19, IT: 2026-05-19, PT: 2026-05-25, RO: 2026-05-25, ES: 2026-05-25, SE: 2026-05-19, NL: 2026-05-21, SK: 2026-05-18, DE: 2026-06-12, PL: 2026-05-25

Condition(s): Primary Progressive Multiple Sclerosis (PPMS)
Product: Orelabrutinib, Placebo tablets match with that of orelabrutinib (ICP-022) tablets in appearance, shape, size, and weight.

Primary endpoint: 1. Time to onset of composite confirmed disability progression (cCDP) events, confirmed over at least 12 weeks (12-week cCDP), defined as follows: * Expanded Disability Status Scale (EDSS) score increase ≥ 1.0 point from baseline when the baseline score is ≤ 5.0, or ≥ 0.5 points from baseline when the baseline score is > 5.0, OR, * ≥ 20% increase in the Timed 25-Foot Walk Test (T25FWT), OR * ≥ 20% increase in the 9-Hole Peg Test (9HPT)

Source: https://euclinicaltrials.eu/ctis-public/view/2025-524316-11-00